EU clinical trial 2024-510799-19-00: A Phase 1b/2a Multicenter, Open-label, Dose Escalation Study to Determine the Maximum Tolerated Dose, Assess the Safety, Tolerability, Pharmacokinetics and Efficacy of CC-220 as Monotherapy and in Combination with Other Treatments in Subjects with Multiple Myeloma
Protocol code: CC-220-MM-001
Sponsor: Celgene Corp. (Pharmaceutical company). Phase: Phase I and Phase II (Integrated)- Other. Countries: France (ongoing, recruitment ended), Italy (ongoing, recruitment ended), Spain (ongoing, recruitment ended), Germany (ongoing, recruitment ended), Netherlands (ongoing, recruitment ended).
Therapeutic area(s): Diseases [C] - Neoplasms [C04]
Gender: Female, Male. Age: 18-64 years, 65+ years. Enrolment: 221.
Status: Ongoing, recruitment ended. Start date (EU): 2016-08-09. Decision date: 2024-07-09. Results received: No. Last updated: 2026-03-27.
Decision dates by country: ES: 2024-07-10, DE: 2024-07-12, NL: 2024-07-11, IT: 2024-07-15, FR: 2024-07-09

Condition(s): Multiple Myeloma
Product: Iberdomide, Iberdomide, Iberdomide, Iberdomide, Dexamethasone Tablets BP 2.0mg, Iberdomide, Iberdomide, Iberdomide, Dexamethasone 2mg Tablets , Iberdomide, Iberdomide, DARZALEX 1800 mg solution for injection, Iberdomide, Iberdomide, Iberdomide, Dexamethason-ratiopharm® 4 mg Tabletten

Primary endpoint: Establish the maximum tolerated doses and or Recommended Phase 2 doses of CC-220 monotherapy, in combination with DEX, and in combination with DEX and daratumumab in combination with DEX and bortezomib, and in combination with DEX and carfilzomib., Overall response rate (ORR) in Cohort D -Tumor response, including progressive disease (PD) according to the International Myeloma Working Group (IMWG) Uniform Response Criteria (Kumar, 2016) in CC-220 in combination with DEX
Endpoint(s): Safety - Type, frequency, seriousness and severity of adverse events (AEs) (and AEs of special interest) and relationship of AEs to investigational product, Very good partial response or better rate (VGPR) - Tumor response, including progressive disease (PD) according to the International Myeloma Working Group (IMWG) Uniform Response Criteria for subjects who achieved VGPR or better., Overall response rate (ORR) - Tumour response, including progressive disease (PD) according to the International Myeloma Working Group (IMWG) Uniform Response Criteria for subjects who achieved partial response (PR) or better, Time to response (TTR) - Time from enrollment to the first documentation of response (PR or greater)., Duration of response (DOR)- Time from the first documentation of response (PR or greater) to the first documentation of PD., Progression free survival (PFS) - Time from the first dose of investigational product (IP) to the first documentation of PD or death from any cause, whichever occurs first., Overall Survival (OS) in Part 2 RRMM cohorts- Time from first dose of IP to death due to any cause., Pharmacokinetic (PK) parameters- PK of CC-220, and as appropriate, its R-enantiomer CC-17195 in plasma, eg, area under the plasma concentration-time curve from time zero to tau, where tau is the dosing interval (AUC(TAU)), maximum plasma concentration of drug (Cmax), time to Cmax (Tmax)

Source: https://euclinicaltrials.eu/ctis-public/view/2024-510799-19-00